EU clinical trial 2022-500790-14-00: An Open Label, Phase 2 Study to Evaluate the Effect of A3907 on Safety, Tolerability, Pharmacokinetics, and Pharmacodynamics in Adults with Primary Sclerosing Cholangitis (PSC)
Protocol code: A3907-002
Sponsor: Albireo AB (Pharmaceutical company). Phase: Therapeutic exploratory (Phase II). Countries: Spain (ended), Italy (ended), France (ended), Poland (ended).
Therapeutic area(s): Diseases [C] - Digestive System Diseases [C06]
Gender: Female, Male. Age: 18-64 years. Enrolment: 26.
Status: Ended. Start date (EU): 2023-01-02. End date (EU): 2025-07-10. Decision date: 2022-12-15. Results received: Yes. Last updated: 2024-12-17.
Decision dates by country: ES: 2022-12-19, FR: 2022-12-19, PL: 2024-05-31, IT: 2022-12-15

Condition(s): Primary Sclerosing Cholangitis (PSC)
Product: A3907

Primary endpoint: The primary endpoint is safety and tolerability as determined by the incidence of treatment-emergent adverse events (TEAEs) through Week 12
Endpoint(s): • PK parameters for A3907 including, but not limited to, Cmax, and area under the plasma AUC • Change from Baseline to Week 12 in serum and urine individual and total bile acid levels • Change from baseline to Week 12 in liver transaminases (ALT and AST), GGT, ALP and total and direct bilirubin levels. • Change from Baseline to Week 12 in 7α-hydroxy-4-cholesten-3-one (C4)

Source: https://euclinicaltrials.eu/ctis-public/view/2022-500790-14-00